EU clinical trial 2023-505270-15-00: The effects of tirzepatIDE on coronAry pLaque lipid content and myocardial microvascular function in people with overweight or obesity and CORonary disease
Sponsor: Steno Diabetes Center Copenhagen (Hospital/Clinic/Other health care facility). Phase: Phase III and phase IV (Integrated). Countries: Denmark (ongoing, recruiting).
Therapeutic area(s): Diseases [C] - Cardiovascular Diseases [C14]
Gender: Female, Male. Age: 18-64 years, 65+ years. Enrolment: 124.
Status: Ongoing, recruiting. Start date (EU): 2024-08-19. Decision date: 2024-07-03. Results received: No. Last updated: 2026-04-12.

Condition(s): Overweight and obesity
Product: SALINE, Mounjaro 15 mg solution for injection in pre-filled pen

Primary endpoint: Between-group difference in change from baseline to week 52 in participants treated with tirzepatide vs placebo: Lipid core burden index of the three major coronary vessels (LCBI(total)) measured by NIRS imaging.
Endpoint(s): Between-group difference in change from baseline to week 52 in participants treated with tirzepatide vs placebo: Total coronary plaque burden measured by coronary intravascular ultrasound (IVUS) imaging assessed by percent atheroma volume (PAV), Between-group difference in change from baseline to week 52 in participants treated with tirzepatide vs placebo: Number of high-risk coronary lesions characterized by maximum lipid core burden index of a 4 mm examined vessel (maxLCBI(4mm)) ≥325 and plaque burden ≥70%, Between-group difference in change from baseline to week 52 in participants treated with tirzepatide vs placebo microvascular function assessed by invasive coronary thermodilution technique (CFR)

Source: https://euclinicaltrials.eu/ctis-public/view/2023-505270-15-00